EU clinical trial 2023-503494-38-00: A Multicenter, Double-Blind, Placebo-Controlled, Randomized Withdrawal Study to Evaluate the Safety and Maintenance of Efficacy of Ecopipam in Children, Adolescents and Adults with Tourette’s Disorder
Protocol code: EBS-101-TD-301
Sponsor: Emalex Biosciences Inc. (Pharmaceutical company). Phase: Therapeutic confirmatory (Phase III). Countries: France (ended), Italy (ended), Poland (ended), Denmark (ended), Germany (ended), Bulgaria (ended), Hungary (ended), Spain (ended), Romania (ended).
Therapeutic area(s): Diseases [C] - Nervous System Diseases [C10]
Gender: Female, Male. Age: 0-17 years, 18-64 years. Enrolment: 99.
Status: Ended. Start date (EU): 2023-07-20. End date (EU): 2025-01-16. End date: 2025-02-04. Decision date: 2023-06-02. Results received: Yes. Last updated: 2024-11-08.
Decision dates by country: RO: 2023-10-23, BG: 2023-06-12, FR: 2023-06-06, DE: 2023-06-06, ES: 2023-06-02, PL: 2023-06-07, IT: 2023-06-06, DK: 2023-06-06, HU: 2023-06-07

Condition(s): Tourette’s Disorder
Product: Ecopipam 67.2 mg, Ecopipam 22.4 mg, Ecopipam 11.2 mg, Ecopipam 89.6 mg, Ecopipam Placebo tablet oral use, Ecopipam 44.8 mg, Ecopipam 33.6 mg

Primary endpoint: Time from Randomization (Week 12) to Relapse in subjects ≥ 6 and < 18 years for ecopipam compared to placebo during the double-blind, R/WD period.
Endpoint(s): Time from Randomization (Week 12) to Relapse in all subjects irrespective of age for ecopipam compared to placebo during the double-blind R/WD period.

Source: https://euclinicaltrials.eu/ctis-public/view/2023-503494-38-00